EU clinical trial 2024-513676-18-00: A Phase 3, Open-Label, Multicenter, Extension Study of Acoramidis in Patients with Newly Diagnosed Variant Transthyretin Amyloid Cardiomyopathy (ACT-EARLY OLE)
Protocol code: AG10-504
Sponsor: Eidos Therapeutics Inc. (Pharmaceutical company). Phase: Therapeutic confirmatory (Phase III). Countries: Germany (authorised, recruitment pending), Portugal (authorised, recruitment pending), Netherlands (authorised, recruitment pending), France (authorised, recruitment pending), Spain (authorised, recruitment pending), Italy (authorised, recruitment pending), Ireland (authorised, recruitment pending), Belgium (authorised, recruitment pending), Sweden (authorised, recruitment pending), Denmark (authorised, recruitment pending), Greece (authorised, recruitment pending).
Therapeutic area(s): Diseases [C] - Cardiovascular Diseases [C14]; Diseases [C] - Nervous System Diseases [C10]
Gender: Female, Male. Age: 18-64 years, 65+ years. Enrolment: 117.
Status: Authorised, recruitment pending. Decision date: 2025-10-22. Results received: No. Last updated: 2026-03-31.
Decision dates by country: DE: 2025-10-28, IT: 2025-10-27, PT: 2025-10-23, NL: 2025-10-24, IE: 2025-10-31, FR: 2025-10-22, SE: 2026-02-20, ES: 2025-10-29, DK: 2026-03-06, GR: 2026-02-02, BE: 2026-02-18

Condition(s): Transthyretin Amyloidosis
Product: Acoramidis (AG10)

Primary endpoint: Proportion of participants with: treatment-emergent AEs and SAEs, AEs leading to treatment discontinuation, abnormal physical examination findings of clinical relevance, abnormal vital signs of clinical relevance, abnormal ECG parameters ofclinical relevance, changes in clinical safety laboratory parameters of potential concern
Endpoint(s): 1. All-cause mortality and cardiovascular mortality, 2. Cardiovascular-related hospitalization, 3. Participants with: • Any HF event: O-HF and/or UV-HF and/or H-HF • UV-HF and/or H-HF • O-HF • UV-HF • H-HF • NOHF, 4. Development of symptomatic ATTR-CM as defined by the investigator, 5. New arrhythmia and cardiac conduction complications (not otherwise attributable to a non-amyloid cause) as defined by: • New onset of atrial fibrillation or atrial flutter and/or • Sustained ventricular tachycardia or sudden cardiac death and/or • New onset 1st or 2nd degree atrioventricular block and/or • Conduction disease requiring temporary transvenous or permanent pacemaker implantation, 6. New diagnosis of or therapeutic surgery (not otherwise attributable to a non-amyloid cause) for: • Carpal tunnel syndrome and/or • Brachial biceps tendon rupture or Achilles tendon rupture and/or • Lumbar spinal stenosis and/or • Hip and knee osteoarthritis and/or • Trigger finger and/or • Rotator cuff osteoarthritis, 7. Change from baseline in: o Echocardiographic and strain parameters that estimate myocardial structure and function o NT-proBNP and hsTnI

Source: https://euclinicaltrials.eu/ctis-public/view/2024-513676-18-00